EU clinical trial 2022-502667-38-00: (20289) A Phase 2 Basket Study of the Oral TRK Inhibitor larotrectinib in Subjects with NTRK Fusion-Positive Tumors
Protocol code: 20289
Sponsor: Bayer Consumer Care AG, Bayer AG (Pharmaceutical company). Phase: Therapeutic exploratory (Phase II). Countries: Spain (ended), Germany (ended), Denmark (ended), Sweden (ended), France (ended), Portugal (ended).
Therapeutic area(s): Diseases [C] - Neoplasms [C04]
Gender: Female, Male. Age: 18-64 years, 65+ years. Enrolment: 41.
Status: Ended. Start date (EU): 2016-06-20. End date (EU): 2025-09-29. End date: 2025-09-30. Decision date: 2024-01-19. Results received: Yes. Last updated: 2025-06-05.
Decision dates by country: PT: 2024-01-22, DK: 2024-01-22, DE: 2024-01-24, SE: 2024-01-23, FR: 2024-01-19, ES: 2024-01-23

Condition(s): Solid tumors harboring NTRK fusion
Product: Larotrectinib Bayer, Larotrectinib Bayer, Larotrectinib Bayer

Primary endpoint: Best overall response of confirmed complete response (CR) or partial response (PR) as determined by an independent radiology review committee using RECIST v1.1 or RANO criteria, as appropriate to tumor type.
Endpoint(s): Best overall response of confirmed CR or PR as determined by the treating Investigator using RECIST v1.1 or RANO criteria, as appropriate to tumor type, Duration of response (DOR): determined for subjects with best overall response of confirmed CR or PR by 1) an independent radiology review committee and 2) the treating Investigator, Clinical benefit rate (CBR): best overall response of confirmed CR, PR, or stable disease lasting 16 or more weeks following the initiation of Larotrectinib, Rate of subjects that have any tumor regression as a best response, measured as shrinkage of target lesions, Progression-free survival (PFS), Overall survival (OS), Comparison of PFS following initiation of Larotrectinib to that following the line of therapy immediately preceding Larotrectinib in each subject who has received prior therapy, Number of subjects with AEs categorized by severity. (including all, serious, and those considered treatment related.), Changes from baseline in clinical safety laboratory values and vital signs, The concordance of prior molecular profiling that detected NTRK fusion within the subject’s tumor with the diagnostic test being evaluated by the sponsor

Source: https://euclinicaltrials.eu/ctis-public/view/2022-502667-38-00